EU clinical trial 2025-521052-35-00: A Phase I First-in-Human Dose Escalation Trial to Evaluate the Safety and Efficacy of ARI-HER2 (HER2BBz CAR-T Cells) in Patients with HER2Positive Advanced Breast Cancer
Protocol code: ARI-HER2
Sponsor: Fundacio De Recerca Clinic Barcelona-Institut D’Investigacions Biomediques August Pi I Sunyer (Laboratory/Research/Testing facility). Phase: Phase I and Phase II (Integrated)- First administration to humans. Countries: Spain (not authorised).
Therapeutic area(s): Diseases [C] - Neoplasms [C04]; Analytical, Diagnostic and Therapeutic Techniques and Equipment [E] - Diagnosis [E01]; Phenomena and Processes [G] - Immune system processes [G12]; Analytical, Diagnostic and Therapeutic Techniques and Equipment [E] - Therapeutics [E02]; Diseases [C] - Female Urogenital Diseases and Pregnancy Complications [C13]
Gender: Female, Male. Age: 18-64 years. Enrolment: 18.
Status: Not authorised. Decision date: 2025-10-15. Results received: No. Last updated: 2025-10-15.

Condition(s): Patients with HER2Positive Advanced Breast Cancer

Source: https://euclinicaltrials.eu/ctis-public/view/2025-521052-35-00